EU clinical trial 2022-501697-19-01: A Phase 3, Randomized Study to Compare Nemtabrutinib Versus Comparator (Investigator’s Choice of Ibrutinib or Acalabrutinib) in Participants With Untreated Chronic Lymphocytic Leukemia/Small Lymphocytic Lymphoma (BELLWAVE-011)
Protocol code: MK-1026-011
Sponsor: Merck Sharp & Dohme LLC (Pharmaceutical company). Phase: Therapeutic confirmatory (Phase III). Countries: Czechia (ongoing, recruiting), Germany (ongoing, recruiting), Norway (ongoing, recruiting), Spain (ongoing, recruiting), Belgium (ongoing, recruiting), Poland (ongoing, recruiting), Greece (ongoing, recruiting), Denmark (ongoing, recruiting), Portugal (ongoing, recruiting), Sweden (ongoing, recruiting).
Therapeutic area(s): Diseases [C] - Neoplasms [C04]
Gender: Female, Male. Age: 18-64 years, 65+ years. Enrolment: 407.
Status: Ongoing, recruiting. Start date (EU): 2024-06-18. Decision date: 2024-06-12. Results received: No. Last updated: 2026-07-08.
Decision dates by country: BE: 2024-07-01, NO: 2024-06-13, DK: 2024-06-27, SE: 2024-07-08, CZ: 2024-06-12, ES: 2024-06-17, PL: 2024-07-17, PT: 2024-06-26, DE: 2024-06-13, GR: 2024-07-22

Condition(s): Small Lymphocytic Lymphoma (SLL) / Untreated Chronic Lymphocytic Leukemia (CLL)
Product: IBRUTINIB, ACALABRUTINIB, Nemtabrutinib, Nemtabrutinib, Nemtabrutinib, Nemtabrutinib

Primary endpoint: Objective Response Rate (ORR) per Chronic Lymphocytic Leukemia (iwCLL) Criteria 2018 as assessed by Blinded Independent Central Review (BICR), Progression-Free Survival (PFS) per iwCLL Criteria 2018 as assessed by BICR
Endpoint(s): Overall Survival (OS), Duration of Response (DOR) per iwCLL Criteria 2018 as assessed by BICR, Number of Participants Who Experience One or More Adverse Events (AEs), Number of Participants Who Discontinue Study Treatment Due to an AE

Source: https://euclinicaltrials.eu/ctis-public/view/2022-501697-19-01